EU clinical trial 2025-521999-56-00: A study to test a single administration of three dose levels of ATX101 in healthy adults.
Protocol code: ATX101-CLN-1001
Sponsor: Aurobac Therapeutics S.A.S. (Pharmaceutical company). Phase: Human Pharmacology (Phase I)- Other. Countries: Portugal (ended).
Therapeutic area(s): Diseases [C] - Bacterial Infections and Mycoses [C01]
Gender: Female, Male. Age: 18-64 years. Enrolment: 24.
Status: Ended. Start date (EU): 2025-07-16. End date (EU): 2025-10-24. Decision date: 2025-07-07. Results received: No. Last updated: 2025-10-10.

Condition(s): Treatment of vascular hyperpermeability in patients with sepsis and septic shock.

Source: https://euclinicaltrials.eu/ctis-public/view/2025-521999-56-00